EU clinical trial 2024-519066-49-01: Electrochemotherapy versus standard radiotherapy for the treatment of basal cell carcinoma
Sponsor: Region Hovedstaden (Hospital/Clinic/Other health care facility). Phase: Therapeutic use (Phase IV). Countries: Denmark (ongoing, recruiting).
Therapeutic area(s): Diseases [C] - Neoplasms [C04]; Diseases [C] - Skin and Connective Tissue Diseases [C17]
Gender: Female, Male. Age: 18-64 years, 65+ years. Enrolment: 52.
Status: Ongoing, recruiting. Start date (EU): 2020-11-16. Decision date: 2024-12-16. Results received: No. Last updated: 2024-12-16.

Condition(s): Basal cell carcinoma (non-melanoma skin cancer)
Product: Bleomycin ”Baxter”, pulver til injektions- og infusionsvæske, opløsning

Primary endpoint: Effect of electhrochemotherapy versus standard radiotherapy for the treatment of basal cell carcinomas less than 3 cm.
Endpoint(s): Adverse events, Cosmesis, Patient satisfaction

Source: https://euclinicaltrials.eu/ctis-public/view/2024-519066-49-01